EU clinical trial 2024-511985-34-00: Clairance de la morPHinE et filtration glomérulaire chez le Drepanocytaire en crise en REAnimation_PHEDREA
Protocol code: DR230314
Sponsor: Centre Hospitalier Regional Universitaire De Tours (Hospital/Clinic/Other health care facility). Phase: Therapeutic use (Phase IV). Countries: France (authorised, recruiting).
Therapeutic area(s): Diseases [C] - Respiratory Tract Diseases [C08]; Phenomena and Processes [G] - Circulatory and Respiratory Physiological Phenomena [G09]; Diseases [C] - Pathological Conditions, Signs and Symptoms [C23]; Diseases [C] - Hemic and Lymphatic Diseases [C15]; Diseases [C] - Cardiovascular Diseases [C14]; Health Care [N] - Health Care Facilities, Manpower, and Services [N02]
Gender: Female, Male. Age: 18-64 years, 65+ years. Enrolment: 100.
Status: Authorised, recruiting. Start date (EU): 2026-03-05. Decision date: 2025-07-15. Results received: No. Last updated: 2025-10-08.

Condition(s): Evaluation of the CKD-Epi score to identify a glomerular filtration threshold predictive of morphine failure at usual dosage, using a reference method for assessing renal function: iohexol clearance. All other aspects of the protocol are part of standard care practice.
Product: Iohexol 300 mg I/ml solution for injection, MORPHINE (CHLORHYDRATE) RENAUDIN 1 mg/ml, solution injectable

Primary endpoint: The primary endpoint was the area under the ROC curve for prediction of therapeutic failure by GFR according to CKD Epi. Therapeutic failure is defined by a percentage of relief assessed by EVN (numerical verbal scale) not reaching 30% in 24h (Darbari, 2017).
Endpoint(s): Clearance of morphine and its metabolites M3G and M6G, Total morphine dose administered over 24 hours and 7 days, Evolution of pain by EVN and EVA (delta over 24h) and PGIC scale at 24h follow-up, Patient-controlled analgesia (PCA) regimen and other coadministered analgesics, Morphine side effects, including impaired alertness, bradypnea, hypercapnia, pruritus, constipation, bloating, nausea, vomiting, acute urinary retention, Correlation between GFR estimated by CKD Epi in basal st

Source: https://euclinicaltrials.eu/ctis-public/view/2024-511985-34-00